EU clinical trial 2024-511317-38-00: Clinical Utility of Liquid Biopsy as a tool to assess the evolution of brigatinib treated patients with non-small cell lung cancer with EML4-ALK translocation: an exploratory study (CUBIK)
Sponsor: Fundacion GECP (Patient organisation/association). Phase: Therapeutic exploratory (Phase II). Countries: Spain (ended).
Therapeutic area(s): Diseases [C] - Neoplasms [C04]
Gender: Female, Male. Age: 18-64 years, 65+ years. Enrolment: 33.
Status: Ended. Start date (EU): 2020-05-04. End date (EU): 2026-07-31. Decision date: 2024-03-11. Results received: No. Last updated: 2026-04-22.

Condition(s): ALK+ non-small cell lung cancer
Product: Alunbrig 30 mg film-coated tablets

Primary endpoint: Overall response rate
Endpoint(s): Duration of response (DOR), Intracranial overall response rate, PFS rate at 1 year and 2 years, Overall Survival (OS) rate at 1 year and 2 years, Safety and tolerability of brigatinib

Source: https://euclinicaltrials.eu/ctis-public/view/2024-511317-38-00